EU clinical trial 2024-514403-34-00: An Open-Label Extension of Study HGT-MLD-070 Evaluating Long Term Safety and Efficacy of Intrathecal Administration of HGT-1110 in Patients with Metachromatic Leukodystrophy
Protocol code: HGT-MLD-071
Sponsor: Shire Human Genetic Therapies Inc. (Pharmaceutical company). Phase: Phase I and Phase II (Integrated)- Other. Countries: Czechia (ended), Denmark (ended), Germany (ended), France (ended), Italy (ended).
Therapeutic area(s): Diseases [C] - Nervous System Diseases [C10]
Gender: Female, Male. Age: 0-17 years. Enrolment: 10.
Status: Ended. Start date (EU): 2012-10-10. End date (EU): 2026-01-26. End date: 2026-02-13. Decision date: 2024-10-02. Results received: No. Last updated: 2026-02-10.
Decision dates by country: CZ: 2024-10-02, DK: 2024-10-03, FR: 2024-10-31, DE: 2024-10-02, IT: 2024-12-16

Condition(s): Late Metachromatic Leukodystrophy (MLD)
Product: rhASA

Primary endpoint: Safety will be measured by the following endpoints: Reporting of treatment-emergent adverse events., Change from baseline in clinical laboratory testing (serum chemistry including liver function tests, hematology, and urinalysis)., Change from baseline in vital signs, physical examinations, and CSF chemistries (including cell counts, glucose, albumin, and protein); as of 15 March 2022, CSF albumin will not be collected., Determination of the presence of anti-HGT-1110 antibodies in CSF and/or serum.
Endpoint(s): 1a. Change from baseline at end of study in motor function using the Gross Motor Function Measure-88 (GMFM-88) total score., 1b. The motor function assessments (GMFM-88, global impression of motor function-change [GIMF-C], and global impression of motor function-severity [GIMF-S]) will no longer be collected when patients reach Gross Motor Function Classification System (GMFCS) level 5, 2. Change from baseline at end of study in the adaptive behavior composite standard score as measured by the VABS-II; as of 12 October 2021, VABS-II will not be collected, 3. Change from baseline at end of study in the domain-specific Caregiver Observed MLD Functioning and Outcomes Reporting Tool (COMFORT) scores, 4. Repeated-dose PK parameter estimates for HGT-1110 in serum, 5. Concentrations of HGT-1110 in CSF at selected time points after repeated investigational drug product administration

Source: https://euclinicaltrials.eu/ctis-public/view/2024-514403-34-00